EU clinical trial 2024-511008-17-00: (LAX) A Randomized, open label, Non-inferiority trial on the efficacy of Lacosamide versus Duloxetine in Patients with Chemotherapy-induced Polyneuropathy - A strategy trial
Sponsor: Leids Universitair Medisch Centrum (LUMC) (Hospital/Clinic/Other health care facility). Phase: Therapeutic use (Phase IV). Countries: Netherlands (ended).
Therapeutic area(s): Diseases [C] - Nervous System Diseases [C10]
Gender: Female, Male. Age: 18-64 years, 65+ years. Enrolment: 110.
Status: Ended. End date (EU): 2026-03-03. Decision date: 2024-07-29. Results received: No. Last updated: 2024-07-29.

Condition(s): chemotherapy-induced neuropathic pain
Product: Cymbalta 30 mg hard gastro-resistant capsules, Vimpat 50 mg film-coated tablets

Primary endpoint: Pain intensity score during the last 4 weeks of treatment
Endpoint(s): Patient satisfaction of treatment, Side effect profile

Source: https://euclinicaltrials.eu/ctis-public/view/2024-511008-17-00